EU clinical trial 2023-506565-57-00: A Randomised, Placebo-Controlled, Double-Blind, Multi-Centre, 4-week, 3-way Crossover Pharmacodynamic Study to Assess the Equivalence of Budesonide, Glycopyrronium, and Formoterol Fumarate (BGF) Delivered by MDI HFO Compared with BGF Delivered by MDI HFA in Participants with Chronic Obstructive Pulmonary Disease
Protocol code: D5985C00002
Sponsor: Astrazeneca AB (Pharmaceutical company). Phase: Therapeutic confirmatory (Phase III). Countries: Hungary (ended), Bulgaria (ended), Poland (ended).
Therapeutic area(s): Diseases [C] - Respiratory Tract Diseases [C08]
Gender: Female, Male. Age: 18-64 years, 65+ years. Enrolment: 49.
Status: Ended. Start date (EU): 2024-06-21. End date (EU): 2025-07-14. End date: 2025-08-12. Decision date: 2024-03-25. Results received: No. Last updated: 2025-08-11.
Decision dates by country: HU: 2024-03-19, PL: 2024-05-15, BG: 2024-03-25

Condition(s): Moderate to Severe Chronic Obstructive Pulmonary Disease(COPD)
Product: Trixeo Aerosphere 5 micrograms/7.2 micrograms/160 micrograms pressurised inhalation, suspension, SALBUTAMOL, Placebo MDI HFA to match BGF MDI HFA, Trixeo Aerosphere 5 micrograms/7.2 micrograms/160 micrograms pressurised inhalation, suspension

Primary endpoint: a)To assess the equivalence of BGF MDI HFO relative to BGF MDI HFA on change from baseline in FEV(1)AUC(0-4), b) To assess the equivalence of BGF MDI HFO relative to BGF MDI HFA on change from baseline in morning pre-dose trough FEV(1), c) To demonstrate assay sensitivity via superiority of BGF MDI HFA relative to placebo MDI HFA on change from baseline in FEV(1) AUC(0-4), d) To demonstrate assay sensitivity via superiority of BGF MDI HFA relative to placebo MDI HFA on change from baseline in morning pre-dose trough FEV(1
Endpoint(s): Safety: a) AEs b) Vital signs (systolic and diastolic blood pressure, pulse rate), Exploratory: a) Change from baseline in FEV(1) AUC(0-4) at TP 1, Exploratory: b) Time to onset defined as the first post-dose timepoint where the mean change from baseline in FEV1 exceeds 100 mL on TP 1, Exploratory: c) To demonstrate assay sensitivity via superiority of BGF MDI HFO relative to placebo MDI HFA on change from baseline in FEV(1)AUC(0-4) at Day 29, Exploratory: d) To demonstrate assay sensitivity via superiority of BGF MDIHFO relative to placebo MDI HFA on change from baseline in morning pre-dose trough FEV(1) at Day 29

Source: https://euclinicaltrials.eu/ctis-public/view/2023-506565-57-00